EU clinical trial 2024-515172-12-00: A Randomized, Double-blind, Vehicle-controlled Phase 2 Study to Evaluate Efficacy, Safety, and Tolerability of Topically Applied TCP-25 in Patients with Epidermolysis Bullosa
Protocol code: TCP25-002
Sponsor: Xinnate AB (Pharmaceutical company). Phase: Therapeutic exploratory (Phase II). Countries: Italy (authorised, recruiting), Spain (ongoing, recruiting), France (ongoing, recruiting), Greece (ongoing, recruiting), Sweden (ongoing, recruiting).
Therapeutic area(s): Diseases [C] - Skin and Connective Tissue Diseases [C17]
Gender: Female, Male. Age: 0-17 years, 18-64 years, 65+ years. Enrolment: 26.
Start date (EU): 2025-12-23. Decision date: 2024-12-16. Results received: No. Last updated: 2026-07-06.
Decision dates by country: SE: 2024-12-16, GR: 2024-12-16, ES: 2024-12-17, IT: 2024-12-17, FR: 2024-12-16

Condition(s): Epidermolysis Bullosa
Product: Sterile agent for cutaneous application, identical to the composition of the TCP-25 gel, except it will not contain the active pharmaceutical ingredient, TCP-25

Primary endpoint: Efficacy of TCP-25 gel as compared with the vehicle in terms of open index wound area until Day 56 relative to the baseline.
Endpoint(s): Key secondary point: Efficacy of TCP-25 gel as compared with the vehicle in terms of proportions of index wounds achieving complete closure of index wound (defined as 100% re-epithelialization without drainage), within Day 56., Change in procedural pain using the Wong Baker FACES® Pain Rating Scale Change from baseline in clinical impression of the index wound using the CGI-S scale and the CGI-C score, TCP-25 plasma concentrations Frequency, intensity, and seriousness of Adverse Events in all treated patients Local tolerability assessment at the area of IMP application Clinically significant changes from baseline in vital signs (systolic and diastolic blood pressure and pulse rate) and physical examination

Source: https://euclinicaltrials.eu/ctis-public/view/2024-515172-12-00